EU clinical trial 2023-506409-20-00: A study to determine how BI 907828 (Brigimadlin) is taken up in the tumor (Phase 0) and to determine the highest dose of BI 907828 (Brigimadlin) that could be tolerated (Phase Ia) in combination with radiation therapy in people with a brain tumor called glioblastoma
Protocol code: 1403-0007
Sponsor: Boehringer Ingelheim International GmbH, Boehringer Ingelheim Espana S.A. (Pharmaceutical company). Phase: Human Pharmacology (Phase I)- Other. Countries: Belgium (ended), Spain (ended).
Therapeutic area(s): Diseases [C] - Neoplasms [C04]
Gender: Female, Male. Age: 18-64 years, 65+ years. Enrolment: 14.
Status: Ended. Start date (EU): 2023-11-24. End date (EU): 2025-07-31. End date: 2025-08-01. Decision date: 2023-11-06. Results received: No. Last updated: 2025-07-25.
Decision dates by country: BE: 2023-11-06, ES: 2023-11-13

Condition(s): Glioblastoma

Source: https://euclinicaltrials.eu/ctis-public/view/2023-506409-20-00